EU clinical trial 2023-505219-19-00: A Phase 1/2, Multicenter, Open-label, Study to Determine the Recommended Dose and Regimen, and Evaluate the Safety and Preliminary Efficacy of CC-92480 in Combination with Standard Treatments in Subjects with Relapsed or Refractory Multiple Myeloma (RRMM) and Newly Diagnosed Multiple Myeloma (NDMM)
Protocol code: CC-92480-MM-002
Sponsor: Celgene Corp. (Pharmaceutical company). Phase: Phase I and Phase II (Integrated)- Other. Countries: Spain (ongoing, recruitment ended), Greece (ended), Germany (ongoing, recruitment ended), Italy (ongoing, recruitment ended), Denmark (ended), France (ongoing, recruitment ended).
Therapeutic area(s): Diseases [C] - Neoplasms [C04]
Gender: Female, Male. Age: 18-64 years, 65+ years. Enrolment: 86.
Start date (EU): 2019-09-03. Decision date: 2024-07-05. Results received: No. Last updated: 2026-04-30.
Decision dates by country: DK: 2024-07-08, GR: 2024-07-19, ES: 2024-07-10, FR: 2024-07-05, IT: 2024-07-10, DE: 2024-07-08

Condition(s): Relapsed or refractory multiple myeloma (RRMM) and newly diagnosed MM (NDMM)
Product: DARZALEX 20 mg/mL concentrate for solution for infusion, Kyprolis 60 mg powder for solution for infusion, Empliciti 400 mg powder for concentrate for solution for infusion., Dexamethason CF 20 mg/ml, injectievloeistof, Dexamethasone 2mg Tablets, VELCADE 3.5 mg powder for solution for injection, DARZALEX 1800 mg solution for injection, Dexamethason 4 mg JENAPHARM®, CC-92480, Dexamethason-ratiopharm® 4 mg Tabletten, CC-92480, CC-92480

Primary endpoint: Recommend Dose and Regimen: Review of dose-limiting toxicities (DLTs), safety, and if applicable, pharmacokinetics (PK), pharmacodynamics (Pd), and/or preliminary efficacy data by the Safety Review Committee (SRC)., Safety: Type, frequency, seriousness and severity of adverse events (AEs), and relationship of AEs to study treatment., Overall response rate (ORR): Best response ≥ partial response (PR), according to the International Myeloma Working Group (IMWG) Uniform Response Criteria.
Endpoint(s): Time-to-response (TTR) Time from first dose to the first documentation of response (PR or greater), Duration of response (DOR) Time from the first documentation of response (PR or greater) to the first documentation of progressive disease (PD) or death, Complete Response (CR) rate Percentage of subjects who achieved CR or better according to IMWG Uniform Response Criteria, Very good partial response (VGPR) rate (Cohorts D and E) Percentage of subjects who achieved VGPR or better according to IMWG Uniform Response Criteria.

Source: https://euclinicaltrials.eu/ctis-public/view/2023-505219-19-00